EU clinical trial 2024-512173-27-00: NIRVANA-Lung : PD-1 iNhibitor and chemotherapy with concurrent IRradiation at VAried tumour sites in advanced Non-small cell lung cAncer
Protocol code: UC-0107/1718
Sponsor: Unicancer (Hospital/Clinic/Other health care facility). Phase: Therapeutic confirmatory (Phase III). Countries: France (ongoing, recruiting).
Therapeutic area(s): Diseases [C] - Neoplasms [C04]
Gender: Female, Male. Age: 18-64 years, 65+ years. Enrolment: 327.
Status: Ongoing, recruiting. Start date (EU): 2019-03-21. Decision date: 2024-10-29. Results received: No. Last updated: 2025-11-03.

Condition(s): Advanced (stage IIIB/IIIC/IV) NSCLC patients eligible for treatment with a PD-1 antagonist (pembrolizumab) according to the European Marketing Authorisation in a first line
Product: PEMETREXED, PEMBROLIZUMAB, CISPLATIN, PACLITAXEL, PACLITAXEL ALBUMIN-BOUND, CARBOPLATIN

Primary endpoint: The primary endpoint of this trial is overall survival (OS) defined as the time from randomization to the date of documented death from any cause or last follow-up. OS rate will be reported at 1 year.
Endpoint(s): Acute/ late toxicity will be assessed according to the flowchart and graded by CTCAE v5 (toxic death and serious adverse events), Tumour response is defined as the percentage of patients with a complete response (CR) or partial response (PR), according to RECIST 1.1 and iRECIST (centralized response evaluation)., Overall survival (OS) is defined as the time from randomization to the date of documented death from any cause or last follow-up. OS rate will be reported at 2 years., Progression-free survival (PFS) or iPFS [Seymour, 2017] are defined as the time from randomization until documented disease progression (PD) according to RECIST 1.1 and iRECIST (centralized response evaluation for both arms), or death, or last follow-up for patient alive whichever occurs first. PFS rate will be reported at 1 year., Cancer specific survival (CSS) is defined as the time from randomization to documented death from cancer from the treatment. CSS rate will be reported at 1 year., Local and distant controls in irradiated patients are defined as the time from randomization to the first documented loco-regional event or distant event. Control rates will be reported at 6 months and 1 year, Quality of life will be assessed using self-administered questionnaires (EORTC QLQ-C30) according to the flowchart.

Source: https://euclinicaltrials.eu/ctis-public/view/2024-512173-27-00